EU clinical trial 2023-507084-19-00: (22551) A single arm, open-label, multicenter Phase 2 study of regorafenib in participants who have been treated in a previous Bayer-sponsored regorafenib study (monotherapy or combination treatment) that has reached the primary completion endpoint, or main data analysis, or has been stopped prematurely.
Protocol code: 22551
Sponsor: Bayer AG (Pharmaceutical company). Phase: Therapeutic exploratory (Phase II). Countries: Spain (ended), France (ongoing, recruitment ended).
Therapeutic area(s): Diseases [C] - Neoplasms [C04]
Gender: Female, Male. Age: 0-17 years, 18-64 years, 65+ years. Enrolment: 5.
Start date (EU): 2024-03-07. Decision date: 2024-02-19. Results received: No. Last updated: 2026-02-25.
Decision dates by country: ES: 2024-02-19, FR: 2024-03-15

Condition(s): Solid malignant tumors
Product: BAY 73-4506, BAY 734506

Primary endpoint: Number of participants with serious adverse events (SAEs) and protocol-specified AEs and their severity
Endpoint(s): Number of participants with dose modifications

Source: https://euclinicaltrials.eu/ctis-public/view/2023-507084-19-00